EU clinical trial 2023-508820-37-00: A Phase 3, Randomized, Observer-Blind, Placebo-Controlled Study to Evaluate the Efficacy, Safety, and Immunogenicity of mRNA-1647 Cytomegalovirus (CMV) Vaccine in Healthy Participants 16 to 40 Years of Age
Protocol code: mRNA1647-P301
Sponsor: Moderna Inc. (Pharmaceutical company). Phase: Therapeutic confirmatory (Phase III). Countries: Finland (ended), Italy (ended), Spain (ended), France (ended), Belgium (ended), Germany (ended), Estonia (ended).
Therapeutic area(s): Diseases [C] - Virus Diseases [C02]
Gender: Female, Male. Age: 0-17 years, 18-64 years. Enrolment: 1853.
Status: Ended. Start date (EU): 2022-02-03. End date (EU): 2025-11-04. End date: 2025-11-05. Decision date: 2024-02-16. Results received: Yes. Last updated: 2025-10-10.
Decision dates by country: BE: 2024-06-17, FI: 2024-02-19, EE: 2024-02-21, DE: 2024-02-20, FR: 2024-06-17, ES: 2024-02-19, IT: 2024-02-20

Condition(s): Cytomegalovirus Infection (CMV)
Product: mRNA-1647, Sodium Chloride 0.9%, Solution for Injection

Primary endpoint: • Primary CMV infection, defined as seroconversion from a negative to a positive result for serum IgG as measured by a platform-based automated immunoassay based on at least 1 of the 4 recombinant CMV antigens not encoded by mRNA-1647 (pp150, pp28, pp52, pp38) assessed starting 28 days after the third injection., • Solicited ARs through 7 days after each injection, unsolicited AEs through 28 days after each injection, MAAEs from Day 1 through 6 months after the last injection, AESIs from Day 1 through EOS, and SAEs from time of consent through EOS.
Endpoint(s): •Antigen-specific nAb and binding antibody GMTs or GMCs on Day 1, Month 3, Month 7, and Month 12. •Antigen-specific nAb and binding antibody GMTs or GMCs on Month 18, Month 24, and Month 30., • Systemic viral dissemination defined as seroconversion as described in the primary efficacy endpoint AND meeting one of the following PCR criteria during the post seroconversion period: a) Positive CMV PCR results in both blood and urine (concurrently or at different timepoints) OR b) Positive CMV PCR results in urine at ≥2 timepoints, • CMV PCR results in urine at each post seroconversion timepoint and during the entire post-seroconversion period.

Source: https://euclinicaltrials.eu/ctis-public/view/2023-508820-37-00